EU clinical trial 2023-504348-32-01: Acetic Acid in Cutaneous Ulcers. Randomized Controlled Trial.
Protocol code: CSAPG-33
Sponsor: Consorci Sanitari De L'Alt Penedes I Garraf (Hospital/Clinic/Other health care facility). Phase: Therapeutic exploratory (Phase II). Countries: Spain (ongoing, recruiting).
Therapeutic area(s): Diseases [C] - Skin and Connective Tissue Diseases [C17]
Gender: Female, Male. Age: 18-64 years, 65+ years. Enrolment: 104.
Status: Ongoing, recruiting. Start date (EU): 2025-04-27. Decision date: 2023-10-13. Results received: No. Last updated: 2026-01-16.

Condition(s): Skin ulcer
Product: ACETIC ACID, GLACIAL

Primary endpoint: Change in ulcer area (percentage of baseline area) 8 weeks after start of treatment
Endpoint(s): Percentage of participants with ulcer healing 4 weeks after starting treatment, Percentage of participants with ulcer healing at 12 weeks from the start of treatment., Time (days) to ulcer healing from start of treatment., Time (days) until hospital discharge from the CSAPG, according to the clinical history record., Changes in the wound bed at 8 weeks according to section 6 of the RESVECH 2.0 scale, Number of adverse reactions associated with the treatment, collected from the clinical history., Healthcare expense associated with each branch of the study, using the center's billing data associated with the use of resources by the insured

Source: https://euclinicaltrials.eu/ctis-public/view/2023-504348-32-01